EU clinical trial 2024-512639-58-00: First-in-human, open-label, multicenter, Phase I/IIa, dose-escalation trial with expansion cohorts to evaluate safety and preliminary efficacy of BNT142 in patients with CLDN6-positive advanced solid tumors
Protocol code: BNT142-01
Sponsor: BioNTech SE (Pharmaceutical company). Phase: Phase I and Phase II (Integrated)- First administration to humans. Countries: Netherlands (ended), Spain (ended), Germany (ended).
Therapeutic area(s): Diseases [C] - Neoplasms [C04]
Gender: Female, Male. Age: 18-64 years, 65+ years. Enrolment: 119.
Status: Ended. Start date (EU): 2022-05-07. End date (EU): 2025-12-03. End date: 2025-12-22. Decision date: 2024-07-01. Results received: Yes. Last updated: 2026-03-09.
Decision dates by country: ES: 2024-07-01, NL: 2024-07-03, DE: 2024-07-08

Condition(s): Solid Tumors
Product: BNT142

Primary endpoint: Occurrence of treatment-emergent adverse events (TEAEs) including Grade ≥3, serious, or fatal TEAEs by causal relationship to trial treatment., Occurrence of dose reductions and discontinuation of BNT142 due to TEAEs., Part 1: Occurrence of dose-limiting toxicities (DLTs) during the DLT evaluation period in the dose escalation., Part 2: Objective response rate (ORR) is defined as the proportion of patients in whom a confirmed complete response (CR) or partial response (PR), per RECIST 1.1, and per GCIG criteria incorporating RECIST 1.1 and CA 125 for the ovarian cancer population is the best overall response
Endpoint(s): Pharmacokinetics (PK) parameters including but not limited to area under the concentration-time curve in the dosing interval (AUC), Clearance (CL) and volume of distribution (Vd), Maximum observed concentration (Cmax), time to maximum observed concentration (tmax), concentration prior to next dose (Ctrough), minimum observed concentration (Cmin), and half-life (t½)., Objective response rate (ORR) (Part 1 only) is defined as the proportion of patients in whom a confirmed CR or PR, per RECIST 1.1, is the best overall response, Disease control rate (DCR) is defined as the proportion of patients in whom a CR or PR or stable disease (SD) (per RECIST 1.1 [and per GCIG criteria for ovarian cancer patients], SD assessed at least 6 weeks after first dose) as best overall response., Duration of response (DOR) is defined as the time from first objective response (CR or PR per RECIST 1.1) to first occurrence of objective tumor progression (progressive disease per RECIST 1.1) or death from any cause, whichever occurs first.

Source: https://euclinicaltrials.eu/ctis-public/view/2024-512639-58-00